EU clinical trial 2024-517890-26-00: A RANDOMIZED, DOUBLE-BLIND, PLACEBO-CONTROLLED, PHASE 2 STUDY TO ASSESS THE INFLUENCE OF ESTETROL (E4) ON HAIR GROWTH PARAMETERS IN POSTMENOPAUSAL WOMEN WITH FEMALE PATTERN HAIR LOSS (PILOT STUDY)
Sponsor: Estetra (Pharmaceutical company). Phase: Therapeutic exploratory (Phase II). Countries: Germany (ended).
Therapeutic area(s): Phenomena and Processes [G] - Physiological processes [G07]
Gender: Female. Age: 18-64 years, 65+ years. Enrolment: 60.
Status: Ended. Start date (EU): 2023-09-21. End date (EU): 2025-07-28. Decision date: 2024-10-17. Results received: Yes. Last updated: 2024-12-17.

Condition(s): postmenopausal women with vasomotor menopausal symptoms
Product: Film-coated placebo to match estetrol monohydrate (E4) 20mg tablet

Primary endpoint: Change from baseline in TAHC (non-vellus) and TAHW (non-vellus and vellus/vellus like hair) at Week 22 vs placebo; Safety endpoints: Frequency of TE(S)AEs; Categorical changes in physical, TVUS, vital signs, breast exam, and lab results at each time point; Change from baseline in endometrial thickness ; Proportion of women with vaginal bleeding/spotting per 28-day treatment cycle with E4 20 mg or placebo; Proportion of women with amenorrhea per 28-day treatment cycle with E4 20 mg or placebo
Endpoint(s): Change from baseline: in TAHC (non-vellus) at Week 10 vs placebo; in TAHC (vellus/vellus like hair) at Weeks 10 and 22 vs placebo; in TAHW (non-vellus) at Week 10 vs placebo; in TAHW (vellus/vellus like hair) at Weeks 10 and 22 vs placebo; HGA score at Weeks 10 and 22 vs placebo; HGI at Weeks 10 and 22 vs placebo; HGSS score at Weeks 10 and 22 vs placebo; IGA of scalp hair growth at Weeks 10 and 22; Change from baseline in WAA-QoL total score at Week 22 vs placebo

Source: https://euclinicaltrials.eu/ctis-public/view/2024-517890-26-00